EU clinical trial 2024-514615-10-01: Deferoxamine in Aneurysmal Subarachnoid Hemorrhage trial (DASH)
Sponsor: Stichting Radboud universitair medisch centrum (Hospital/Clinic/Other health care facility). Phase: Phase I and Phase II (Integrated)- Other. Countries: Netherlands (ongoing, recruiting).
Therapeutic area(s): Diseases [C] - Nervous System Diseases [C10]; Diseases [C] - Cardiovascular Diseases [C14]
Gender: Female, Male. Age: 18-64 years, 65+ years. Enrolment: 40.
Status: Ongoing, recruiting. Start date (EU): 2025-01-14. Decision date: 2025-01-14. Results received: No. Last updated: 2026-02-16.

Condition(s): Subarachnoid hemorrhage
Product: NaCl 0,9%, Deferoxamine Noridem 500mg Κόνις για ενέσιμο διάλυμα ή διάλυμα για έγχυση

Primary endpoint: The presence of new ischemia at control imaging (2 weeks and 6 months)
Endpoint(s): Serum Ferritin, GOS-E, EQ-5D, mRS

Source: https://euclinicaltrials.eu/ctis-public/view/2024-514615-10-01